EU clinical trial 2023-507867-20-00: (Synbiose-2 )Synergetic B-cell immunomodulation in SLE – 2 nd study
Sponsor: Academisch Ziekenhuis Leiden (Hospital/Clinic/Other health care facility). Phase: Phase II and Phase III (Integrated). Countries: Netherlands (ended).
Therapeutic area(s): Diseases [C] - Immune System Diseases [C20]
Gender: Female, Male. Age: 18-64 years, 65+ years. Enrolment: 30.
Status: Ended. Start date (EU): 2018-10-04. End date (EU): 2026-06-22. Decision date: 2024-08-28. Results received: No. Last updated: 2024-08-28.

Condition(s): Lupus Erythematosus, Systemic
Product: Benlysta 200 mg solution for injection in pre-filled pen., Truxima 100 mg concentrate for solution for infusion

Primary endpoint: Treatment failure rate during the 2 years study period
Endpoint(s): Reduction of disease relevant autoantibodies, in particular anti-dsDNA autoantibody production at 28 weeks, Total renal response rate at 28 weeks, Regression of immune complex-mediated excessive neutrophil extracellular traps (NET) formation at 28 weeks, Sustained, long-term B-cell depletion during 104 weeks, Sustained reduction of relevant anti-nuclear autoantibodies, including seroconversion during 104 weeks, Sustained regression of immune complex-mediated excessive neutrophil extracellular traps (NET) formation during 104 weeks, Safety and toxicity monitoring according to Common toxicity Criteria (CTC) developed by the National Cancer Institute (NCI) with the use of Common Terminology Criteria for Adverse Events (CTCAE), Evaluate the reduction of concomitant immunosuppression and the number of moderate and severe flares during study follow-up

Source: https://euclinicaltrials.eu/ctis-public/view/2023-507867-20-00